EU clinical trial 2023-508767-79-00: A study to test how well different doses of BI 3034701 are tolerated by healthy men and people with overweight or obesity
Protocol code: 1507-0001
Sponsor: Boehringer Ingelheim International GmbH (Pharmaceutical company). Phase: Human Pharmacology (Phase I)- First administration to humans. Countries: Germany (ended).
Therapeutic area(s): Not possible to specify
Gender: Female, Male. Age: 18-64 years, 65+ years. Enrolment: 125.
Status: Ended. Start date (EU): 2024-05-15. End date (EU): 2025-10-07. Decision date: 2024-04-22. Results received: No. Last updated: 2025-04-03.

Condition(s): Healthy volunteer trial

Source: https://euclinicaltrials.eu/ctis-public/view/2023-508767-79-00